EU clinical trial 2024-515929-28-00: C4221008 - A Phase 2, Open-label Study of Encorafenib + Binimetinib in Patients with BRAFV600-mutant Non-small Cell Lung Cancer
Protocol code: C4221008
Sponsor: Pfizer Inc. (Pharmaceutical company). Phase: Therapeutic exploratory (Phase II). Countries: Netherlands (ended), Spain (ended), Italy (ended).
Therapeutic area(s): Diseases [C] - Neoplasms [C04]
Gender: Female, Male. Age: 18-64 years, 65+ years. Enrolment: 59.
Status: Ended. Start date (EU): 2019-08-02. End date (EU): 2025-08-14. End date: 2025-10-03. Decision date: 2024-09-02. Results received: No. Last updated: 2025-08-19.
Decision dates by country: ES: 2024-09-09, IT: 2024-09-10, NL: 2024-09-02

Condition(s): Non-small Cell Lung Cancer
Product: Encorafenib, Mektovi 15 mg film-coated tablets, Braftovi 75 mg hard capsules, Braftovi 50 mg hard capsules, Mektovi 15 mg film-coated tablets, Braftovi 75 mg hard capsules, Braftovi 50 mg hard capsules

Primary endpoint: ORR defined as the proportion of patients who have achieved a confirmed best overall response (CR or PR) as determined by IRR per RECIST v1.1 in the treatment-naïve setting, ORR defined as the proportion of patients who have achieved a confirmed best overall response (CR of PR) as determined by IRR per RECIST v1.1 in the previously treated setting
Endpoint(s): Confirmed ORR by Investigator per RECIST v1.1, DOR (by IRR and by Investigator) defined as the time from the date of the first documented response (CR or PR) that is subsequently confirmed(by IRR and by Investigator, respectively) to the earliest date of disease progression, per RECIST v1.1, or death due to any cause, DCR (by IRR and by Investigator), defined as the proportion of patients who have a confirmed CR or confirmed PR, or SD per RECIST v1.1, PFS (by IRR and by Investigator), defined as the time from the date of first dose of study drug to the earliest date of disease progression, per RECIST v1.1, or death due to any cause., TTR (by IRR and Investigator), defined as the time from the date of first dose to the first documentation of objective response (CR or PR) which is subsequently confirmed (by IRR and by Investigator, respectively)

Source: https://euclinicaltrials.eu/ctis-public/view/2024-515929-28-00